EU clinical trial 2024-519152-82-00: A Phase 3, Multicenter, Randomized, Open Label Study to Compare the Efficacy and Safety of Golcadomide in Combination with Rituximab (Golca + R) Vs Investigator’s Choice in Participants with Relapsed/Refractory Follicular Lymphoma who have Received at least 1 Prior Line of Systemic Therapy (GOLSEEK-4)
Protocol code: CA073-1003
Sponsor: Celgene Corp. (Pharmaceutical company). Phase: Therapeutic confirmatory (Phase III). Countries: Netherlands (ongoing, recruiting), Greece (ongoing, recruiting), Spain (ongoing, recruiting), France (ongoing, recruiting), Poland (ongoing, recruiting), Germany (ongoing, recruiting), Finland (ongoing, recruiting), Italy (ongoing, recruiting).
Therapeutic area(s): Diseases [C] - Hemic and Lymphatic Diseases [C15]
Gender: Female, Male. Age: 18-64 years, 65+ years. Enrolment: 133.
Status: Ongoing, recruiting. Start date (EU): 2025-09-03. Decision date: 2025-07-18. Results received: No. Last updated: 2026-07-14.
Decision dates by country: FR: 2025-07-18, FI: 2025-07-18, NL: 2025-07-18, PL: 2025-07-20, GR: 2025-07-21, ES: 2025-07-22, IT: 2025-07-29, DE: 2025-07-18

Condition(s): Relapsed/Refractory Follicular Lymphoma
Product: BENDAMUSTINE HYDROCHLORIDE, Golcadomide, PREDNISONE, LENALIDOMIDE, DOXORUBICIN HYDROCHLORIDE, LENALIDOMIDE, Golcadomide, RITUXIMAB, BENDAMUSTINE HYDROCHLORIDE, RITUXIMAB, VINCRISTINE SULFATE, CYCLOPHOSPHAMIDE, DOXORUBICIN HYDROCHLORIDE, Golcadomide, LENALIDOMIDE, Golcadomide, LENALIDOMIDE, PEGFILGRASTIM, CYCLOPHOSPHAMIDE, PREDNISOLONE

Primary endpoint: To evaluate time from randomization to the first disease progression based on Lugano 2014 classification guidelines as assessed by Independent Review Adjudication committee (IRAC) or death from any cause, whichever occurs earlier.
Endpoint(s): To evaluate how long a participant lives overall., To evaluate how well the cancer responds to the treatment., To evaluate how long the cancer responds., To evaluate how long it takes for participants to start a new treatment., To evaluate how the treatment impacts the quality of life of participants while they are taking it.

Source: https://euclinicaltrials.eu/ctis-public/view/2024-519152-82-00